EU clinical trial 2024-516370-30-00: A Phase 1 Study of HMPL-306 in Locally Advanced Solid Tumors with IDH mutations
Protocol code: 2020-306-GLOB2
Sponsor: Hutchmed Ltd. (Pharmaceutical company). Phase: Human Pharmacology (Phase I)- Other. Countries: Spain (ended).
Therapeutic area(s): Diseases [C] - Neoplasms [C04]
Gender: Female, Male. Age: 18-64 years, 65+ years. Enrolment: 24.
Status: Ended. Start date (EU): 2021-02-09. End date (EU): 2025-02-27. End date: 2025-02-28. Decision date: 2024-09-04. Results received: No. Last updated: 2024-09-04.

Condition(s): - Locally advanced or metastatic solid tumors; - Cholangiocarcinoma; - Skeletal chondrosarcoma; - Low-grade glioma; - Any other solid tumor harboring an IDH mutation

Source: https://euclinicaltrials.eu/ctis-public/view/2024-516370-30-00